EU clinical trial 2024-516026-56-00: „INSIGHT“ An explorative, open-labeled, phase I trial to evaluate feasibility and safety of eftilagimod alpha (IMP321, a LAG-3Ig fusion protein acting as LAG-3 agonist) in combination with immunotherapeutic, targeted or chemotherapeutic agents or when administered via new routes of application in advanced stage solid tumors
Protocol code: INSIGHT
Sponsor: Frankfurter Institut Fuer Klinische Krebsforschung IKF GmbH (Pharmaceutical company). Phase: Human Pharmacology (Phase I)- Other. Countries: Germany (ongoing, recruitment ended).
Therapeutic area(s): Diseases [C] - Neoplasms [C04]
Gender: Female, Male. Age: 18-64 years, 65+ years. Enrolment: 110.
Status: Ongoing, recruitment ended. Start date (EU): 2017-08-17. Decision date: 2024-10-23. Results received: No. Last updated: 2026-04-15.

Condition(s): Histologically confirmed locally advanced or metastatic solid tumor (Strata A, B, D): Specification for Stratum C: Only patients with NSCLC adenocarcinomas, (squamous or adenosquamous not permitted) who are scheduled to receive platin + pembrolizumab + pemetrexed standard treatment (only for Stratum C) Specification for Stratum E: Including only metastatic or irresectable locally advanced urothelial carcinomas (only for Stratum E)

Source: https://euclinicaltrials.eu/ctis-public/view/2024-516026-56-00